EU clinical trial 2024-511334-12-00: HOVON 147 MM: Carfilzomib, Lenalidomide and Dexamethasone versus Lenalidomide and Dexamethasone in High- Risk Smoldering Multiple Myeloma: A Randomized Phase 2 Study.
Protocol code: HO147
Sponsor: Hemato-Oncologie voor Volwassenen Nederland (Hovon) Stichting (Hospital/Clinic/Other health care facility). Phase: Therapeutic exploratory (Phase II). Countries: Norway (ongoing, recruitment ended), Netherlands (ongoing, recruitment ended).
Therapeutic area(s): Diseases [C] - Neoplasms [C04]
Gender: Female, Male. Age: 18-64 years, 65+ years. Enrolment: 58.
Status: Ongoing, recruitment ended. Start date (EU): 2018-11-19. Decision date: 2024-09-02. Results received: No. Last updated: 2024-09-04.
Decision dates by country: NL: 2024-09-02, NO: 2024-09-04

Condition(s): Smoldering Multiple Myeloma, Multiple Myeloma
Product: Kyprolis 60 mg powder for solution for infusion, Revlimid 10 mg hard capsules, Fortecortin® 2 mg Tabletten, Revlimid 5 mg hard capsules, Dexamethason-ratiopharm® 4 mg Tabletten, Revlimid 15 mg hard capsules, Dexamethason-ratiopharm® 8 mg Tabletten, Revlimid 25 mg hard capsules

Primary endpoint: MRD negativity rate by NGF after cycle 9 for all eligible ITT patients; eligible patients who achieve a MRD negativity after cycle 9 will be considered as a success. All other eligible randomized ITT patients will be considered as a failure, including patients going off-protocol before cycle 9, whatever the cause.
Endpoint(s): MRD negativity rate evaluated by means of next generation flow cytometry (cut off 10-5) after cycle 4, MRD negativity rate evaluated by means of next generation flow cytometry (cut off 10-5) after completion of maintenance, Correlation of MRD (NGF) negativity rate with PFS, Overall response rate (ORR; i.e. at least partial response (PR)) after 9 cycles induction treatment, Progression-free survival (PFS), defined as time from study entry to progression or death, whichever comes first, Progression-free survival-2 (PFS2), defined at time from randomization to progression after second-line treatment or death, whichever comes first, Duration of response (DOR), defined as time from response to progression or death, whichever comes first, Overall survival (OS), defined as time from study entry to death from any cause. Patients still alive at the date last contact will be censored, Correlation of MRD (NGF) negativity rate with PFS, PFS2, DOR and OS, Toxicity of combination therapy (carfilzomib, lenalidomide, and dexamethasone), Safety (type, frequency, and severity of adverse events (AE) and relationship of AE to study drug, serious AE (SAEs), Disease heterogeneity in relation to clinical outcomes (molecular profiling on bone marrow samples)

Source: https://euclinicaltrials.eu/ctis-public/view/2024-511334-12-00